EU clinical trial 2022-502072-23-00: A MULTICENTER OPEN-LABEL, UNCONTROLLED STUDY TO EVALUATE THE PHARMACOKINETICS, PHARMACODYNAMICS, SAFETY, TOLERABILITY, AND ACTIVITY OF ZILUCOPLAN IN PEDIATRIC STUDY PARTICIPANTS FROM 2 TO LESS THAN 18 YEARS OF AGE WITH ACETYLCHOLINE RECEPTOR ANTIBODY POSITIVE GENERALIZED MYASTHENIA GRAVIS
Protocol code: MG0014
Sponsor: UCB Biopharma (Pharmaceutical company). Phase: Phase II and Phase III (Integrated). Countries: Italy (authorised, recruitment pending), Poland (ongoing, recruiting).
Therapeutic area(s): Diseases [C] - Nervous System Diseases [C10]
Gender: Female, Male. Age: 0-17 years. Enrolment: 4.
Start date (EU): 2025-07-11. Decision date: 2023-11-29. Results received: No. Last updated: 2026-06-05.
Decision dates by country: PL: 2023-11-30, IT: 2023-11-29

Condition(s): Generalized Myasthenia Gravis
Product: Zilbrysq 23 mg solution for injection in pre-filled syringe, Zilbrysq 32.4 mg solution for injection in pre-filled syringe, Zilucoplan sodium, Zilbrysq 16.6 mg solution for injection in pre-filled syringe

Primary endpoint: • Plasma concentrations of zilucoplan (ZLP) sampled at Week 4 (Day 29) • Change from Baseline in sheep red blood cell (sRBC) lysis at Week 4 (Day 29) • Change from Baseline in complement component 5 (C5) levels at Week 4 (Day 29)
Endpoint(s): • Occurrence of treatment-emergent adverse events (TEAEs) during the course of the study, • Occurrence of treatment-emergent serious adverse events (TESAE)s, • Occurrence of TEAEs leading to permanent withdrawal of investigational medicinal product (IMP), • Occurrence of treatment-emergent infections, • Occurrence of antidrug antibody (ADA) and anti- polyethylene glycol (PEG) antibodies at Week 4 (Day 29)., • Change in MG-activities of daily living (MG-ADL) score from Baseline to Week 4 (Day 29)., • Change in Quantitative MG (QMG) score from Baseline to Week 4 (Day 29)., • Myasthenia Gravis Foundation of America Post-Interventional Status (MGFA PIS) at Week 4 (Day 29)., • Change in Pediatric Quality of Life Inventory (PedsQoL), Version 4 domain scores from Baseline to Week 4 (Day 29).

Source: https://euclinicaltrials.eu/ctis-public/view/2022-502072-23-00